EU clinical trial 2024-512018-16-00: PEARLDIFER - A Phase II study of pemigatinib after curative local therapy in locally advanced intrahepatic cholangiocarcinoma (iCCA) harboring FGFR2 fusions/rearrangements
Protocol code: PEARLDIFER
Sponsor: Frankfurter Institut Fuer Klinische Krebsforschung IKF GmbH (Pharmaceutical company). Phase: Therapeutic exploratory (Phase II). Countries: Germany (ended).
Therapeutic area(s): Diseases [C] - Neoplasms [C04]
Gender: Female, Male. Age: 18-64 years, 65+ years. Enrolment: 20.
Status: Ended. Start date (EU): 2022-11-11. End date (EU): 2025-03-27. Decision date: 2024-08-19. Results received: Yes. Last updated: 2025-03-18.

Condition(s): locally advanced intrahepatic cholangiocarcinoma (iCCA) with FGFR2 fusions/rearrangements
Product: Pemazyre 4.5 mg tablets

Primary endpoint: Recurrence free survival rate at 12 months (RFS@12)
Endpoint(s): Incidence, treatment relationship, seriousness, and severity of all AEs, SAEs according to CTCAE V5.0, Overall survival (OS), Recurrence free survival (RFS), Effect of therapy on global health status/quality of life and on other symptoms and scales of the EORTC-QLQ-C30, EORTC-QLQ-BIL21 and EQ-5D-5L after 6 and 12 months (proportion of patients with a better, stable, or worse score)

Source: https://euclinicaltrials.eu/ctis-public/view/2024-512018-16-00